EU clinical trial 2025-524564-38-00: A PET Study to Assess the Occupancy of M4 Muscarinic Acetylcholine Receptors by BMS-986521 in Healthy Adult Participants
Protocol code: CN0140003
Sponsor: Bristol-Myers Squibb Services Unlimited Company (Pharmaceutical company). Phase: Human Pharmacology (Phase I)- Other. Countries: Belgium (authorised, recruitment pending).
Therapeutic area(s): Psychiatry and Psychology [F] - Behavior and Behavior Mechanisms [F01]; Psychiatry and Psychology [F] - Mental Disorders [F03]; Diseases [C] - Nervous System Diseases [C10]
Gender: Female, Male. Age: 18-64 years. Enrolment: 12.
Status: Authorised, recruitment pending. Decision date: 2026-05-22. Results received: No. Last updated: 2026-05-22.

Condition(s): Neuropsychiatric indications and potentially other conditions

Source: https://euclinicaltrials.eu/ctis-public/view/2025-524564-38-00